EU clinical trial 2023-508316-27-00: Preoperative Indocyanine Green administration increases intraoperative detection of Liver Tumors in Imaging-guided surgery. A phase IV clinical trial.
Protocol code: LIVERGREEN
Sponsor: Fundacio Hospital Universitari Vall D’Hebron Institut De Recerca (Laboratory/Research/Testing facility). Phase: Therapeutic use (Phase IV). Countries: Spain (ongoing, recruiting).
Therapeutic area(s): Analytical,Diagnostic,Therapeutic Techniques and Equipment [E]-Surgical Procedures, Operative [E04]
Gender: Female, Male. Age: 18-64 years, 65+ years. Enrolment: 173.
Status: Ongoing, recruiting. Start date (EU): 2024-06-10. Decision date: 2024-02-12. Results received: No. Last updated: 2026-07-16.

Condition(s): Patients with liver tumors that will undergo minimally invasive liver surgery
Product: INDOCYANINE GREEN

Primary endpoint: Quantify the intraoperative detection of liver tumors using IOUS and ICG

Source: https://euclinicaltrials.eu/ctis-public/view/2023-508316-27-00